EU clinical trial 2024-514336-24-00: A Phase 3 Study to Evaluate the Efficacy and Safety of ARO-APOC3 in Adults with Familial Chylomicronemia Syndrome
Protocol code: AROAPOC3-3001
Sponsor: Arrowhead Pharmaceuticals Inc. (Pharmaceutical company). Phase: Therapeutic confirmatory (Phase III). Countries: Ireland (ended), France (ended), Spain (ended), Belgium (ended), Croatia (ended), Poland (ended), Austria (ended).
Therapeutic area(s): Phenomena and Processes [G] - Genetic Phenomena [G05]
Gender: Female, Male. Age: 18-64 years, 65+ years. Enrolment: 21.
Status: Ended. Start date (EU): 2022-03-24. End date (EU): 2026-01-21. End date: 2026-04-21. Decision date: 2024-09-26. Results received: No. Last updated: 2026-05-07.
Decision dates by country: AT: 2024-11-11, PL: 2024-09-30, IE: 2024-09-26, ES: 2024-09-26, HR: 2024-09-27, BE: 2024-09-27, FR: 2024-09-26

Condition(s): Familial Chylomicronemia Syndrome (FCS)
Product: ARO-APOC3 PFS, ARO-APOC3, 0.9% Normal Saline for injection

Primary endpoint: Percent change from baseline at Month 10 in fasting TG
Endpoint(s): Percent change from baseline at Months 10 and 12 (averaged) in fasting TG, Percent change from baseline at Month 10 in fasting APOC3, Percent change from baseline at Month 12 in fasting APOC3

Source: https://euclinicaltrials.eu/ctis-public/view/2024-514336-24-00